EU clinical trial 2023-506783-14-00: J2G-MC-JZJC: LIBRETTO-431: A Multicenter, Randomized, Open-Label, Phase 3 Trial Comparing Selpercatinib to Platinum-Based and Pemetrexed Therapy with or without Pembrolizumab as Initial Treatment of Advanced or Metastatic RET Fusion-Positive Non-Small Cell Lung Cancer
Protocol code: J2G-MC-JZJC
Sponsor: Eli Lilly & Co. (Pharmaceutical company). Phase: Therapeutic confirmatory (Phase III). Countries: France (ongoing, recruitment ended), Germany (ongoing, recruitment ended), Spain (ongoing, recruitment ended), Italy (ongoing, recruitment ended), Belgium (ongoing, recruitment ended), Netherlands (ongoing, recruitment ended), Greece (ongoing, recruitment ended).
Therapeutic area(s): Diseases [C] - Neoplasms [C04]
Gender: Female, Male. Age: 18-64 years, 65+ years. Enrolment: 42.
Status: Ongoing, recruitment ended. Start date (EU): 2020-02-24. Decision date: 2024-05-15. Results received: No. Last updated: 2026-07-02.
Decision dates by country: BE: 2024-05-21, GR: 2024-05-24, DE: 2024-05-16, IT: 2024-05-20, FR: 2024-05-21, ES: 2024-05-20, NL: 2024-05-15

Condition(s): Advanced or Metastatic RET Fusion-Positive Non-Small Cell Lung Cancer
Product: SELPERCATINIB, PEMBROLIZUMAB, PEMETREXED, CISPLATIN, CARBOPLATIN, SELPERCATINIB

Primary endpoint: PFS per REIST 1.1 by BICR

Source: https://euclinicaltrials.eu/ctis-public/view/2023-506783-14-00